EU clinical trial 2024-518270-14-00: A double-blinded, Randomized, Parallel, Placebo-controlled trial of Wharton´s Jelly-derived Allogenic Mesenchymal Stromal Cells to treat Type I Diabetes in Children Adolescents (WJMSC-P01)
Protocol code: WJMSC-P01
Sponsor: Region Uppsala (Hospital/Clinic/Other health care facility). Phase: Therapeutic exploratory (Phase II). Countries: Sweden (ongoing, recruiting).
Therapeutic area(s): Diseases [C] - Nutritional and Metabolic Diseases [C18]
Gender: Female, Male. Age: 0-17 years. Enrolment: 66.
Status: Ongoing, recruiting. Start date (EU): 2024-11-12. Decision date: 2024-11-12. Results received: No. Last updated: 2025-04-02.

Condition(s): Type 1 diabetes
Product: ProTrans

Primary endpoint: Safety Safety parameters will be evaluated in the intervention trial at each study visit and recorded as adverse events (AEs). Any grade 3 event (or higher) will be evaluated by DSMB. Efficacy Change in C-peptide Area Under the Curve (AUC) (0-120 min) for Mixed Meal Tolerance Test (MMTT) at 12 months following WJMSC/Placebo infusion when compared to test performed before the start of treatment (baseline).
Endpoint(s): The proportion of study participants independent of insulin (ADA criteria) at 6 and 12 months., The proportion of participants with daily insulin needs <0.25U/kg at 6 and 12 months., Insulin requirement/kg body weight at 6 and 12 months., Glycosylated Hb (HbA1c) and insulin-dose adjusted HbA1c (IDAA1c) at 6 and 12 months., · Time-in-target (4-8 mmol/l) and Time-in-range (3.9-10 mmol/l) as measured by flash glucose monitoring for 14 days at 6 and 12 months., · Change in C-peptide Area Under the Curve (AUC) (0-120 min) for Mixed Meal Tolerance Test (MMTT) at 6 months following WJMSC/Placebo infusion when compared to test performed before the start of treatment (baseline)., Change in peak C-peptide concentration during the first 6 months or the first year after treatment

Source: https://euclinicaltrials.eu/ctis-public/view/2024-518270-14-00